EU clinical trial 2024-513185-19-00: A Phase Ib/II Dose Finding Study Assessing Safety and Efficacy of [177Lu]Lu-DOTA-TATE in Newly Diagnosed Extensive Stage Small Cell Lung Cancer (ES-SCLC) in Combination with Carboplatin, Etoposide and Atezolizumab in Induction and with Atezolizumab in Maintenance Treatment Phase.
Protocol code: CAAA601A42101
Sponsor: Novartis Pharma AG (Pharmaceutical company). Phase: Phase I and Phase II (Integrated)- Other. Countries: Germany (ended), Spain (ongoing, recruitment ended), France (ongoing, recruitment ended), Austria (ongoing, recruitment ended), Belgium (ended), Czechia (ended), Italy (ended), Netherlands (ended).
Therapeutic area(s): Diseases [C] - Neoplasms [C04]
Gender: Female, Male. Age: 18-64 years, 65+ years. Enrolment: 86.
Start date (EU): 2022-07-13. Decision date: 2024-09-02. Results received: No. Last updated: 2026-05-19.
Decision dates by country: NL: 2025-05-27, DE: 2024-09-04, BE: 2025-05-15, IT: 2025-05-12, FR: 2024-10-18, ES: 2024-09-02, AT: 2025-06-11, CZ: 2025-06-10

Condition(s): Extensive stage small cell lung cancer (ES-SCLC)
Product: Lutathera 370 MBq/mL solution for infusion, ATEZOLIZUMAB, Tevimbra 100 mg concentrate for solution for infusion, CARBOPLATIN, LysaKare 25 g/25 g solution for infusion, NETSPOT, ETOPOSIDE

Primary endpoint: Phase Ib: • Frequency of dose limiting toxicities (DLTs), incidence of adverse events (AEs), serious AEs (SAEs), and AEs leading to treatment discontinuation Phase II: • Overall Survival (OS) defined as time from date of randomization to death due to any cause
Endpoint(s): Phase Ib:•ORR,DOR,PFS,OS •TACs •Absorbed radiation doses of [177Lu]Lu-DOTA-TATE in organs and tumor lesions •Concentration of [177Lu]Lu-DOTA-TATE in blood over time and derived PK parameters •Quantification of [177Lu]Lu-DOTA-TATE excreted from the body in urine Phase II:•PFS,ORR,DOR based on investigator assessment as per RECIST 1.1 Phase Ib and Phase II:•Incidence and severity of AEs and SAEs •Incidence and severity of AEs and SAEs within 48 hours after [68Ga]Ga-DOTA-TATE infusion

Source: https://euclinicaltrials.eu/ctis-public/view/2024-513185-19-00